EU clinical trial 2026-525704-98-00: A study in healthy people to compare two tablet formulations of pramipexole
Protocol code: 0248-0690
Sponsor: Boehringer Ingelheim International GmbH (Pharmaceutical company). Phase: Human Pharmacology (Phase I)- Bioequivalence Study. Countries: Germany (ongoing, recruiting).
Therapeutic area(s): Not possible to specify
Gender: Female, Male. Age: 18-64 years. Enrolment: 24.
Status: Ongoing, recruiting. Start date (EU): 2026-08-03. Decision date: 2026-05-22. Results received: No. Last updated: 2026-05-22.

Condition(s): Healthy volunteer trial

Source: https://euclinicaltrials.eu/ctis-public/view/2026-525704-98-00